EU clinical trial 2023-505803-22-00: A Phase 2, randomized, double-blind, placebo-controlled, parallel group, proof-of-concept study assessing the efficacy and safety of amlitelimab in adult participants with moderate to severe hidradenitis suppurativa.
Protocol code: ACT17967
Sponsor: Sanofi-Aventis Research & Development (Pharmaceutical company). Phase: Therapeutic exploratory (Phase II). Countries: Germany (ended), France (ended), Hungary (ended), Spain (ended), Poland (ended), Portugal (ended), Italy (ended).
Therapeutic area(s): Diseases [C] - Immune System Diseases [C20]
Gender: Female, Male. Age: 18-64 years, 65+ years. Enrolment: 49.
Status: Ended. Start date (EU): 2024-04-15. End date (EU): 2025-10-10. End date: 2025-10-11. Decision date: 2024-02-20. Results received: No. Last updated: 2025-12-01.
Decision dates by country: FR: 2024-02-26, HU: 2024-04-22, PT: 2024-02-28, DE: 2024-02-20, ES: 2024-02-26, PL: 2024-02-25, IT: 2024-02-28

Condition(s): Hidradenitis
Product: Amlitelimab, Amlitelimab matching placebo comprised of the same excipients as the Test product without the active substance

Primary endpoint: The clinical response as measured by the percentage of participants achieving HiSCR50 at Week 16
Endpoint(s): Time to onset of achieving HiSCR50, Absolute change from baseline in AN count at Week 16, Percentage change in AN count at Week 16, Percentage of participants achieving HiSCR75 at Week 16, Percentage of participants achieving HiSCR90 at Week 16, Percentage of participants who experience improvement by at least 1 International Hidradenitis Suppurativa Severity Score System (IHS4) stage at Week 16, Change in absolute score from Baseline in IHS4 at Week 16, Percentage of participants who experience a flare at Week 16, Percentage of participants achieving IHS4-55 at Week 16, Percentage of participants achieving at least 30% reduction and at least 1 unit reduction from Baseline in weekly average of daily HS-Skin Pain NRS at Week 16 among participants with baseline NRS ≥3, Percentage of participants with improvement (reduction) in Peak Pruritus Numerical Rating Scale (PP-NRS) ≥4 from Baseline at Week 16 among participants with baseline PP-NRS ≥4, Percentage of participants who experience 5- point reduction in DLQI at Week 16 among participants with baseline DLQI ≥4, Change from Baseline in the total Hidradenitis Suppurativa Quality of Life (HiSQOL) score at Week 16, Incidence of treatment-emergent adverse events (TEAEs), adverse event of special interest (AESIs), and serious adverse events (SAEs) including local injection site reactions in the Safety Population, Incidence of potentially clinically significant abnormalities in laboratory tests, vital signs, and electrocardiograms in the Safety Population, Serum amlitelimab concentrations measured at prespecified time points in the PK population, Incidence of antidrug antibodies (ADA) of amlitelimab at prespecified timepoints in the ADA population

Source: https://euclinicaltrials.eu/ctis-public/view/2023-505803-22-00